EU clinical trial 2023-508547-51-00: Prospective, randomised, double-blind, placebo-controlled multicenter clinical trial of efficacy and safety with Dermatophagoides pteronyssinus and Dermatophagoides farinae mannan-conjugated allergoids in patients with rhinitis/rhinoconjunctivitis, allergic to Dermatophagoides pteronyssinus and/or Dermatophagoides farinae_MM09-SIT-063
Protocol code: MM09-SIT-063
Sponsor: Inmunotek S.L. (Pharmaceutical company). Phase: Therapeutic confirmatory (Phase III). Countries: Spain (ongoing, recruiting), Portugal (authorised, recruitment pending).
Therapeutic area(s): Diseases [C] - Immune System Diseases [C20]
Gender: Female, Male. Age: 0-17 years, 18-64 years, 65+ years. Enrolment: 250.
Start date (EU): 2025-11-18. Decision date: 2025-05-05. Results received: No. Last updated: 2026-07-02.
Decision dates by country: PT: 2025-05-06, ES: 2025-05-05

Condition(s): Aetiological treatment of moderate-to-severe allergic rhinitis/rhinoconjunctivitis with or without mild-to-moderate controlled allergic asthma
Product: Same solution and presentation that active treatment but without active ingredients, Mannan-conjugated allergoid (polymerized) Dermatophagoides pteronyssinus and Dermatophagoides farinae parenteral vaccine

Primary endpoint: Rhinitis/Rhinoconjunctivitis Combined Symptom and Medication Score (RCSMS) by means of the Subject’s Diary
Endpoint(s): Rhinitis/Rhinoconjunctivitis Symptom Score (RSS), Rhinitis/Rhinoconjunctivitis Medication Score (RMS), Asthma-Combined Symptom and Medication Score (ACSMS), Asthma Symptom Score (ASS), Asthma Medication Score (AMS), Asthma and Rhinitis/Rhinoconjunctivitis Symptom Score (ARSS), Asthma and Rhinitis/Rhinoconjunctivitis Medication Score (ARMS), Asthma and Rhinitis/Rhinoconjunctivitis Combined Symptom and Medication Score (ARCSMS), Asthma exacerbations: time to first asthma exacerbation; number, duration, and severity, Immunological parameters: • Total IgE • Specific IgE and IgG4 • Specific IgE/Total IgE ratio • Anti-Saccharomyces cerevisiae antibodies (ASCA) IgA and IgG, Allergen profiling (ALEX technique), Asthma Quality of Life Questionnaire (AQLQ), Rhinoconjunctivitis Quality of Life Questionnaire (RQLQ), Asthma Control Questionnaire (GINA 2023), Visual Analogue Scale (VAS), Consumption of Health Resources, Safety parameters: • Overall rate and severity of adverse events (AEs) per administration and per subject. • Evaluation of reactions at the site of administration, systemic reactions and of any medications administered for the treatment of the adverse reaction (AR).

Source: https://euclinicaltrials.eu/ctis-public/view/2023-508547-51-00